EU clinical trial 2023-505006-41-00: Study is designed to assess the safety and tolerability of ceralasertib at increasing doses in combination with other anti-cancer treatment in patients with advanced tumours
Protocol code: D5330C00004
Sponsor: AstraZeneca AB (Pharmaceutical company). Phase: Human Pharmacology (Phase I)- First administration to humans. Countries: France (ended).
Therapeutic area(s): Diseases [C] - Neoplasms [C04]
Gender: Female, Male. Age: 18-64 years, 65+ years. Enrolment: 100.
Status: Ended. Start date (EU): 2015-05-11. End date (EU): 2025-03-18. Decision date: 2023-09-04. Results received: No. Last updated: 2025-07-01.

Condition(s): QT interval prolongation, Pharmacokinetics, Cancer or Advanced solid malignancies, ATM deficiency, Advanced solid malignancies, Biomarkers

Source: https://euclinicaltrials.eu/ctis-public/view/2023-505006-41-00